EU clinical trial 2024-516058-23-00: OPTIFLU. Prognostic Impact of Early Oseltamivir Carboxylate Low Plasma Concentration in Critically Ill Patients With Severe Influenza: a Prospective Cohort Study
Protocol code: APHP210090
Sponsor: Assistance Publique Hopitaux De Paris (Hospital/Clinic/Other health care facility). Phase: Therapeutic confirmatory (Phase III). Countries: France (ongoing, recruitment ended).
Therapeutic area(s): Diseases [C] - Virus Diseases [C02]
Gender: Female, Male. Age: 18-64 years, 65+ years. Enrolment: 155.
Status: Ongoing, recruitment ended. Start date (EU): 2023-12-18. Decision date: 2024-10-10. Results received: No. Last updated: 2026-02-03.

Condition(s): Adult patients admitted to the ICU for management of severe influenza infection requiring orotracheal intubation for invasive mechanical ventilation
Product: Tamiflu 75 mg hard capsules, DOLIPRANE 1000 mg, poudre pour solution buvable en sachet-dose

Primary endpoint: The primary endpoint is the number of days alive without invasive mechanical ventilation at D28.
Endpoint(s): Diagnostic performance of the paracetamol absorption test (sensitivity, specificity, positive and negative predictive values, positive and negative likelihood ratios) performed at H48 for the diagnosis of plasma oseltamivir underdosing., Prevalence of patients with low plasma OC concentration, Plasma OC underdosage at H48 (dependent variable); the independent variables are the clinical and biological data present on admission, which will be studied as prognostic factors for OC underdosage using univariate and multivariate logistic regression models., Viral clearance, calculated from nasopharyngeal viral load measurements taken on D1 (initial influenza diagnostic test) and D5. The association between viral clearance and plasma OC concentration at H48 will be assessed., Prevalence of acquisition of the H275Y oseltamivir resistance mutation (investigated by PCR and high-throughput sequencing)., Measurements of Cmax and Residual OC and oseltamivir phosphate (OP, inactive prodrug) at D2, D3 and D5, Mortality at D28 and D90 in patients under-dosed in OC at 48h of treatment initiation and in patients not under-dosed

Source: https://euclinicaltrials.eu/ctis-public/view/2024-516058-23-00